EU clinical trial 2024-516324-34-01: Reduction of blood loss in pediatric osteotomies around the hip - A randomized placebo-controlled trial with tranexamic acid
Sponsor: Erasmus Universitair Medisch Centrum Rotterdam (Erasmus MC) (Hospital/Clinic/Other health care facility). Phase: Therapeutic use (Phase IV). Countries: Netherlands (ongoing, recruiting).
Therapeutic area(s): Diseases [C] - Musculoskeletal Diseases [C05]
Gender: Female, Male. Age: 0-17 years. Enrolment: 180.
Status: Ongoing, recruiting. Start date (EU): 2023-04-17. Decision date: 2024-11-21. Results received: No. Last updated: 2024-11-21.

Condition(s): Slipped capital femoral epiphysis (SCFE), Legg-Calvé-Perthes Disease (LCPD), Neuromuscular conditions, Secondary hip dysplasia, Developmental dysplasia of the hip (DDH)
Product: SALINE, TRANEXAMIC ACID

Primary endpoint: Estimated intraoperative blood loss (ml/kg)
Endpoint(s): Baseline demographic data, Indication for surgery, Prior surgery at same site, Treatment characteristics, Operative time, Eventual additional antifibrinolytic agents administered during surgery (including TXA), Blood transfusions, Pre- and postoperative blood values, including Hb, Complications, Duration of hospital stay

Source: https://euclinicaltrials.eu/ctis-public/view/2024-516324-34-01